EU clinical trial 2023-506620-87-00: IMPlementing geriatric assessment for dose Optimization of CDK 4/6-inhibitors in older bReasT cAncer patieNTs – a pragmatic randomized-controlled trial (IMPORTANT trial)
Protocol code: IMPORTANT TRIAL
Sponsor: Region Oerebro Laen (Hospital/Clinic/Other health care facility). Phase: Phase III and phase IV (Integrated). Countries: Italy (ongoing, recruiting), Sweden (ongoing, recruiting), Finland (ongoing, recruiting), Spain (ongoing, recruiting), Norway (ongoing, recruiting), Greece (ongoing, recruiting).
Therapeutic area(s): Diseases [C] - Neoplasms [C04]
Gender: Female, Male. Age: 65+ years. Enrolment: 495.
Status: Ongoing, recruiting. Start date (EU): 2024-01-25. Decision date: 2023-11-27. Results received: No. Last updated: 2026-03-16.
Decision dates by country: NO: 2023-11-28, GR: 2024-09-09, ES: 2023-12-01, SE: 2023-11-27, FI: 2023-11-28, IT: 2024-06-06

Condition(s): Advanced Breast Cancer in older patients
Product: Kisqali 200 mg film-coated tablets, Aromasin 25 mg coated tablets, IBRANCE 125 mg hard capsules, Verzenios 100 mg film-coated tablets, Verzenios 150 mg film-coated tablets, Verzenios 50 mg film-coated tablets, Arimidex® 1 mg film-coated tablets, Faslodex 250 mg solution for injection., Femara 2,5 mg plėvele dengtos tabletės, IBRANCE 100 mg hard capsules, IBRANCE 75 mg hard capsules

Primary endpoint: Time to treatment failure
Endpoint(s): Overall Treatment Utility, Overall survival, Progression free survival, Time to chemotherapy initiation, Toxicity, QoL, Time to QoL deterioration, Cost-effectiveness

Source: https://euclinicaltrials.eu/ctis-public/view/2023-506620-87-00